EU clinical trial 2025-521012-18-00: A Randomized, Double-blind, Placebo-controlled, Phase 3 Study to Evaluate the Efficacy and Safety of Intravenous AOC 1020 for the Treatment of Facioscapulohumeral Muscular Dystrophy (FSHD)
Protocol code: AOC 1020-CS3
Sponsor: Avidity Biosciences Inc. (Pharmaceutical company). Phase: Therapeutic confirmatory (Phase III). Countries: Italy (ongoing, recruiting), France (authorised, recruiting), Germany (ongoing, recruiting), Spain (ongoing, recruiting), Denmark (ongoing, recruiting), Netherlands (ongoing, recruiting).
Therapeutic area(s): Diseases [C] - Musculoskeletal Diseases [C05]
Gender: Female, Male. Age: 18-64 years, 65+ years. Enrolment: 80.
Start date (EU): 2026-04-13. Decision date: 2025-11-04. Results received: No. Last updated: 2026-07-08.
Decision dates by country: IT: 2025-11-07, ES: 2025-11-05, NL: 2025-11-14, DK: 2025-11-14, DE: 2025-11-04, FR: 2025-11-06

Condition(s): Facioscapulohumeral Muscular Dystrophy (FSHD)
Product: 0.9% Saline for IV administration, AOC 1020

Primary endpoint: Change from Baseline to Week 78 in 10MWRT velocity (m/sec)
Endpoint(s): 1.1 Key Secondary Endpoints • Change from Baseline to Week 78 in: o Timed-Up-and-Go (TUG) velocity o NeuroQoL Upper Extremity Function o Quantitative Muscle Testing (QMT) total composite score (PPN), 1.2 Other Secondary Endpoints • Change from Baseline over time in: o Patient-reported Outcomes Measurement Information System instruments (PROMIS) (Physical Function) o PROMIS Fatigue o Worst Pain Numerical Rating Scale (NRS) o Patient Global Impression of Severity (PGI-S)/Patient Global Impression of Change (PGI-C) o Quality of Life in Neurological Disorders (NeuroQoL) Sleep Disturbance o DUX4-regulated plasma KHDC1L o Serum CK

Source: https://euclinicaltrials.eu/ctis-public/view/2025-521012-18-00